EU clinical trial 2024-512906-24-00: Biodistribution Evaluation to Reduce Administered Radiopharmaceutical Dose on LOng Axial Field of VieW PET Scanners – BELOW trial
Sponsor: Het Nederlands Kanker Instituut-Antoni van Leeuwenhoek Ziekenhuis Stichting (Hospital/Clinic/Other health care facility). Phase: Human Pharmacology (Phase I)- Other. Countries: Netherlands (ongoing, recruiting).
Therapeutic area(s): Diseases [C] - Neoplasms [C04]; Analytical, Diagnostic and Therapeutic Techniques and Equipment [E] - Diagnosis [E01]
Gender: Female, Male. Age: 18-64 years, 65+ years. Enrolment: 150.
Status: Ongoing, recruiting. Start date (EU): 2025-03-21. Decision date: 2024-09-16. Results received: No. Last updated: 2026-06-08.

Condition(s): Cancer

Source: https://euclinicaltrials.eu/ctis-public/view/2024-512906-24-00